EU clinical trial 2026-525736-42-00: A PHASE II, SINGLE ARM, OPEN LABEL, MULTICENTER STUDY EVALUATING THE EFFICACY AND SAFETY OF CEVOSTAMAB IN COMBINATION WITH POMALIDOMIDE AND DEXAMETHASONE IN PATIENTS WITH MULTIPLE MYELOMA WHO HAVE RECEIVED A PRIOR BCMA TARGETING CAR T-CELL THERAPY
Protocol code: CO46577
Sponsor: F. Hoffmann-La Roche AG (Pharmaceutical company). Phase: Therapeutic exploratory (Phase II). Countries: Germany (authorised, recruitment pending).
Therapeutic area(s): Diseases [C] - Neoplasms [C04]
Gender: Female, Male. Age: 18-64 years, 65+ years. Enrolment: 45.
Status: Authorised, recruitment pending. Decision date: 2026-07-20. Results received: No. Last updated: 2026-07-20.

Condition(s): Multiple Myeloma (MM)
Product: Cevostamab, Imnovid 2 mg hard capsules, DEXAMETHASONE, Cevostamab, DEXAMETHASONE, DEXAMETHASONE, Imnovid 1 mg hard capsules

Primary endpoint: ORR defined as the proportion of participants with best overall response of PR or better per IMWG criteria
Endpoint(s): VGPR or better rate, defined as the proportion of participants with best overall response of VGPR or better per IMWG criteria, CR or better rate, defined as the proportion of participants with best overall response of CR or sCR per IMWG criteria, DOR, defined as the time from the date of first documented response of PR or better until the first date of disease progression or death from any cause, whichever occurs first, PFS, defined as the time from enrollment to the earliest date of disease progression per IMWG criteria or death due to any cause, whichever occurs first, OS, defined as the time from enrollment to death due to any cause, MRD-negative CR rate at 9 months measured in bone marrow aspirate by NGS is defined as the proportion of participants who achieve CR or better, and MRD negativity at a threshold of 10-5 at 9 months (± 90 days) after enrollment and before disease progression or start of subsequent anti-myeloma therapy, Overall MRD-negative CR rate, defined as proportion of participants who achieve CR or better and MRD negativity (10-5 threshold) at any timepoint, before disease progression or start of subsequent anti-myeloma therapy, TTR, defined as time from enrollment to first achieving a PR or better by IMWG criteria, TTBR, defined as time from enrollment to achieving the earliest date of achieving best response by IMWG criteria, PFS2, defined as time from enrollment to disease progression after initiation of new antimyeloma therapy, or death from any cause, whichever is earlier. If disease progression after initiation of new antimyeloma therapy cannot be measured, a PFS2 event is defined as the date of discontinuation of new antimyeloma therapy or death from any cause, whichever is earlier, Time to confirmed deterioration in Disease Symptoms Scale, defined as an increase in 16 points or more from baseline followed by a second deterioration at a subsequent assessment, as assessed by the European Organisation for Research and Treatment of Cancer Quality of Life Questionnaire-Multiple Myeloma Module 20 (EORTC QLQ-MY20), Time to confirmed deterioration in GHS/QoL, defined as a decrease in 10 points or more from baseline followed by a second deterioration at a subsequent assessment, as assessed by the European Organisation for Research and Treatment of Cancer Quality of Life Questionnaire-Core 30 (EORTC QLQ-C30), Incidence and severity of adverse events, with severity determined according to the NCI CTCAE v5.0 and ASTCT Consensus Grading for CRS (Lee et al. 2019), ICANS (Lee et al. 2019), and HLH/IEC-HS (Hines et al. 2023), Change from baseline in selected vital signs, Change from baseline in selected clinical laboratory test results, Tolerability as assessed by the incidence of dose interruptions, dose reductions, dose intensity, and treatment discontinuation, Change from baseline in disease symptoms scale of the EORTC QLQ MY20, Change from baseline in GHS/QoL scale of the EORTC QLQ C30, Change from baseline in fatigue as assessed by the EORTC QLQ C30, Time to confirmed deterioration in fatigue, defined as an increase in 10 points or more from baseline followed by a second deterioration at a subsequent assessment, as assessed by the EORTC QLQ C30, Proportion of participants experiencing a clinically meaningful improvement in disease symptoms while on treatment, defined as a decrease in 16 points or more from baseline as assessed by the EORTC QLQ MY20, Proportion of participants experiencing a clinically meaningful improvement in GHS/QoL while on treatment, defined as an increase in 10 points or more from baseline as assessed by the EORTC QLQ C30, Proportion of participants experiencing a clinically meaningful improvement in fatigue while on treatment, defined as a decrease in 10 points or more from baseline as assessed by the EORTC QLQ C30, Prevalence of anti-drug antibody (ADA) against cevostamab at baseline and incidence of ADA against cevostamab during the study

Source: https://euclinicaltrials.eu/ctis-public/view/2026-525736-42-00